EU clinical trial 2024-516811-25-00: Phase 2, Randomized, Double-Blind, Placebo-Controlled Multicenter Study of CVN424 in Parkinson’s Disease Patients with Motor Complications
Protocol code: CVN424-301
Sponsor: Cerevance Beta Inc. (Pharmaceutical company). Phase: Therapeutic exploratory (Phase II). Countries: Czechia (ongoing, recruitment ended), Poland (ongoing, recruitment ended), France (ended), Spain (ongoing, recruitment ended), Italy (ended).
Therapeutic area(s): Diseases [C] - Nervous System Diseases [C10]
Gender: Female, Male. Age: 18-64 years, 65+ years. Enrolment: 148.
Start date (EU): 2025-05-15. Decision date: 2025-04-02. Results received: No. Last updated: 2026-06-24.
Decision dates by country: PL: 2025-04-06, FR: 2025-04-04, ES: 2025-04-02, IT: 2025-04-03, CZ: 2025-04-03

Condition(s): Parkinson Disease
Product: CVN424, CVN424, film-coated tablets for oral administration

Primary endpoint: 1. Change from Baseline to Week 12 in average daily OFF time on motor diaries for 150 mg CVN424 compared to placebo (normalized to waking hours).
Endpoint(s): 1. Change from baseline to end of the study treatment (week 12) compared to placebo assessed in several questionnaires and scales used during the study., 2. Safety is assessed by the number of patients reporting treatment emergent adverse events and serious adverse events; number of patients with clinically significant changes in the physical examination, vital signs, 12-lead ECG and laboratory data.

Source: https://euclinicaltrials.eu/ctis-public/view/2024-516811-25-00